EU clinical trial 2024-515160-32-00: A Multicenter, Proof-of-concept, Phase 2 Study to Evaluate the Safety, Tolerability, Pharmacokinetics, and Pharmacodynamics of HM15912 in Adult Subjects with Short Bowel Syndrome-associated Intestinal Failure (SBS-IF) (DOLPHINS-2)
Protocol code: HM-GLP2-201
Sponsor: Hanmi Pharm. Co. Ltd. (Pharmaceutical company). Phase: Therapeutic exploratory (Phase II). Countries: France (ongoing, recruiting), Germany (ongoing, recruiting), Poland (ongoing, recruiting), Denmark (ongoing, recruiting), Belgium (ongoing, recruiting).
Therapeutic area(s): Diseases [C] - Digestive System Diseases [C06]
Gender: Female, Male. Age: 18-64 years, 65+ years. Enrolment: 13.
Status: Ongoing, recruiting. Start date (EU): 2022-02-02. Decision date: 2024-08-05. Results received: No. Last updated: 2026-08-07.
Decision dates by country: BE: 2024-08-06, FR: 2024-09-02, DK: 2024-08-05, DE: 2024-08-08, PL: 2024-08-09

Condition(s): Short Bowel Syndrome-associated Intestinal Failure (SBS-IF)
Product: Solution for injection in pre-filled syringe

Primary endpoint: Primary endpoints to assessment of safety and tolerability of HM15912 after multiple subcutaneous (SC) doses for 24 weeks: • Incidence of adverse events (AEs) • Incidence of injection site reactions • Incidence of clinical laboratory abnormalities • Clinically significant findings on physical examination • Changes from baseline in vital signs and 12-lead electrocardiogram (ECG) parameters, Primary endpoints to assessment of the pharmacokinetic (PK) profile of HM15912: • Maximum serum concentration (Cmax) • Time to maximum serum concentration (tmax) • Elimination half-life (t1/2) • Volume of distribution (Vd/F) • Clearance (CL/F) • Area under the concentration-time curve from time zero to the last observable concentration (AUClast), AUC from time zero over the dosing interval at the 1st and 6th dosing, respectively (AUCtau and AUCtau,ss), and AUC extrapolated to infinity
Endpoint(s): Change in weekly parenteral nutrition/intravenous fluid (PN/IV) volume from baseline to Week 25 Note: The baseline PN/IV volume (L/week) is the average of actual PN/IV volume received during the last 2 weeks of the Stabilization period.

Source: https://euclinicaltrials.eu/ctis-public/view/2024-515160-32-00